EU clinical trial 2023-509496-16-00: PEMBROCABOSARC : COMBINATION OF PEMBROLIZUMAB AND CABOZANTINIB IN PATIENTS WITH ADVANCED SARCOMAS
Protocol code: IB 2020-02
Sponsor: Institut Bergonie (Hospital/Clinic/Other health care facility). Phase: Therapeutic exploratory (Phase II). Countries: France (ongoing, recruiting).
Therapeutic area(s): Diseases [C] - Neoplasms [C04]
Gender: Female, Male. Age: 18-64 years, 65+ years. Enrolment: 99.
Status: Ongoing, recruiting. Start date (EU): 2022-04-21. Decision date: 2024-10-15. Results received: No. Last updated: 2026-07-30.

Condition(s): Advanced /metastatic sarcomas: undifferentiated pleomorphic sarcoma, osteosarcoma and Ewing sarcoma.
Product: CABOMETYX 40 mg film-coated tablets, CABOMETYX 20 mg film-coated tablets, KEYTRUDA 25 mg/mL concentrate for solution for infusion

Primary endpoint: The primary efficacy endpoint for advanced undifferentiated pleomorphic sarcoma (stratum 1), advanced osteosarcoma (stratum 2) and advanced Ewing sarcoma (stratum 3) is 6-month non-progression (as per RECIST evaluation criteria v1.1)., Non-progression: complete response, partial response or stable disease more than 24 weeks as per RECIST evaluation criteria v1.1., Objective response: complete response or partial response as per RECIST evaluation criteria v1.1., Following RECIST v1.1 recommendations: o claimed responses (complete or partial response) will have to be confirmed at least 4 weeks later; o 6-month radiological data will be reviewed by an independent expert radiologist. o Primary efficacy analysis will be based on the central radiological review data. o Each patient will be assigned one of the following categories: Complete response, Partial response, Stable disease, Progression, not evaluated for response.
Endpoint(s): Best overall response defined as per RECIST v1.1 criteria., 1-year progression-free survival (PFS): PFS is defined as the time from study treatment initiation to the first occurrence of disease progression or death (of any cause), whichever occurs first., 1-year overall survival (OS): OS is defined as the time from study treatment initiation to death (of any cause)., Growth modulation index (GMI), defined for each patient as the ratio of the PFS on the current treatment strategy to the PFS on the previous line of therapy (Von Hoff, 1998), in patients with documented progression at inclusion., Toxicity will be graded using the Common Terminology Criteria for Adverse Events (CTCAE) from the NCI v5.0., Immune-related response is defined according to iRECIST (Seymour 2017). Analysis will be based on data centrally reviewed by an expert radiologist., 7. Performance of pharmacodynamic (PD)/mechanism of action (MOA) biomarkers analysis as well as predictive biomarkers analysis (levels of angiogenic and immunologic biomarkers) in blood and tumor tissue at baseline and different study time points., 7. a) Blood samples will be mandatory collected at predefined timepoints for assessment of, 7. b) Serum/plasma cytokines levels (TNFγ, TNFα, TGFβ, IL2, 4, 6, 10), VEGF, HGF, sMET, sVEGFR2 (ELISA), 7. c) Treg, CD4+ CD8+ and DR lymphocytes subpopulations monitoring, CD8+/Treg ratio (flow cytometry), 7. d) Plasma levels of Kynurenine and Kynurenine to Tryptophan ratio (ELISA and LC/MS), 7. e) Availability of a < 3 months, non subsequently treated or fresh tumor samples, with frozen material available will be mandatory at inclusion for baseline, and a second sampling will be collected (optional) during treatment at C2Day8* (+/- 3 days). Formalin-fixed, paraffin-embedded biopsy samples will be analysed for (but not limited to) CD8+ effectors, CD68 and 163 Macrophages and FOXP3+ cells infiltrates as well as PDL1, IDO1, CD31 (microvessel density),, 7. e) as well as MET and phosphoMET, Ki67 expression by IHC. Frozen samples will be analysed by (but not limited to) RNA sequencing in search for a predictive signature for response. * biopsy at C2D8 will be collected under patient agreement end with discernment.

Source: https://euclinicaltrials.eu/ctis-public/view/2023-509496-16-00